EU clinical trial 2024-515393-27-00: A randomized, double-blind, placebo-controlled, Phase 2 study evaluating efficacy and safety of inupadenant in combination with carboplatin and pemetrexed in adults with nonsquamous non-small cell lung cancer who have progressed on immunotherapy
Protocol code: A2A-005
Sponsor: iTeos Belgium (Pharmaceutical company). Phase: Therapeutic exploratory (Phase II). Countries: Spain (ended), Czechia (ended), France (ended), Belgium (ended), Germany (ended), Italy (ended).
Therapeutic area(s): Diseases [C] - Neoplasms [C04]
Gender: Female, Male. Age: 18-64 years, 65+ years. Enrolment: 131.
Status: Ended. End date (EU): 2025-10-24. End date: 2025-10-25. Decision date: 2024-09-17. Results received: Yes. Last updated: 2025-06-10.
Decision dates by country: BE: 2024-09-18, CZ: 2024-09-17, FR: 2024-09-27, DE: 2024-09-18, IT: 2024-10-16, ES: 2024-09-17

Condition(s): Nonsquamous non-small cell lung cancer, Nonsquamous non-small cell lung cancer
Product: Inupadenant HCl, Placebo to Inupadenant, Inupadenant HCl

Primary endpoint: Part 1 (Dose-Finding): Incidence of adverse events (AEs), serious adverse events (SAEs), dose-limiting toxicities (DLTs), AEs leading to dose-modifications or discontinuation, deaths, and clinically significant laboratory abnormalities., Part 2 (Randomized): Progression-free survival (PFS), defined as time from randomization to the date of first documented radiological progression using Response Evaluation Criteria in Solid Tumors (RECIST) v1.1 criteria or death due to any cause
Endpoint(s): Part 1: ORR; DoR; percent CTS from baseline; DCR, PFS, OS., Part 2: Incidence and frequency of AEs, SAEs, and AEs leading to dose modifications or discontinuation, deaths, and clinically significant laboratory abnormalities., Part 2: ORR; DoR; percent CTS from baseline; DCR; OS., Part 2: Time to definitive deterioration in global health status/quality of life (QoL), shortness of breath and pain per EORTC QLQ-C30 questionnaire. Please refer to Protocol for other secondary endpoints.

Source: https://euclinicaltrials.eu/ctis-public/view/2024-515393-27-00